EU clinical trial 2025-521843-19-00: Efficacy of Tuvusertib in Recurrent IDH mutant Astrocytoma with ATRX mutation, a phase II prospective trial.
Protocol code: GEINO-2401
Sponsor: Grupo Espanol De Investigacion En Neurooncologia (Laboratory/Research/Testing facility). Phase: Therapeutic exploratory (Phase II). Countries: Spain (ongoing, recruiting).
Therapeutic area(s): Diseases [C] - Neoplasms [C04]
Gender: Female, Male. Age: 18-64 years, 65+ years. Enrolment: 56.
Status: Ongoing, recruiting. Start date (EU): 2025-12-19. Decision date: 2025-11-11. Results received: No. Last updated: 2025-11-11.

Condition(s): IDH1/2-mutated, ATRX-mutated and p53-mutated astrocytoma
Product: M1774, M1774

Primary endpoint: The primary endpoint will be the 6-months PFS rate, defined as the proportion of patients alive and free of progression according to RANO 2.0 estimated by Kaplan-Meier at 6 months after the first dose of tuvusertib.
Endpoint(s): Objective response (ORR) locally assessed by PI according to RANO 2.0., Progression-free survival (PFS) locally assessed by PI according to RANO 2.0., Overall survival (OS)., TTNI Time to Next Intervention., Neurocognitive function using HVLT, TMT-A, TMT.B and COWA, and tests., Neurologic status: NANO scale and MMSE test., Functional status: Barthel index and Karnofsky index., Patients reported outcomes through the NCI-PRO-CTCAE Custom Survey and PGIC Questionnaires, Adverse events (AE)., Treatment-related AEs (TRAEs)., Treatment compliance, number of dose reductions / interruptions.

Source: https://euclinicaltrials.eu/ctis-public/view/2025-521843-19-00